EU clinical trial 2025-522832-16-00: Intermediate versus standard dose enoxaparin to prevent venous thromboembolism in severe trauma patients: a multicenter double blind randomised controlled trial (HEPTRAUMA)
Protocol code: 38RC23.0261
Sponsor: Centre Hospitalier Universitaire Grenoble Alpes (Hospital/Clinic/Other health care facility). Phase: Phase II and Phase III (Integrated). Countries: France (authorised, recruitment pending).
Therapeutic area(s): Analytical,Diagnostic,Therapeutic Techniques and Equipment [E]-Surgical Procedures, Operative [E04]; Diseases [C] - Hemic and Lymphatic Diseases [C15]; Analytical, Diagnostic and Therapeutic Techniques and Equipment [E] - Anesthesia and Analgesia [E03]
Gender: Female, Male. Age: 18-64 years, 65+ years. Enrolment: 540.
Status: Authorised, recruitment pending. Decision date: 2025-12-11. Results received: No. Last updated: 2025-12-11.

Condition(s): Severe trauma
Product: LOVENOX 30 000 UI (300 mg)/3 ml, solution injectable, PLACEBO _ HEPTRAUMA, LOVENOX 30 000 UI (300 mg)/3 ml, solution injectable, LOVENOX 30 000 UI (300 mg)/3 ml, solution injectable

Primary endpoint: Composite of symptomatic deep vein thrombosis, proximal deep vein thrombosis, pulmonary embolism within 14 days following randomisation after severe trauma
Endpoint(s): Key secondary endpoint (included in a sequential hierarchical testing procedure): Composite of major venous thromboembolism, as defined in the primary endpoint, and major bleedings, defined by (i) the need for a haemostatic invasive procedure because of bleeding, (ii) the need for interruption of prophylactic enoxaparin for ≥48 hours because of bleeding, or (iii) bleeding in a critical organ within 14 days following randomisation after a severe trauma, Other endpoints: Major or clinically relevant non-major bleeding, as per ISTH definition, occurring during or within 48h of the last dose of study drug; Incidence of major venous thromboembolism (as defined in the primary endpoint) and major bleeding (as per ISTH definition) at day 30 following randomisation; death at day 30 following randomisation

Source: https://euclinicaltrials.eu/ctis-public/view/2025-522832-16-00